EU clinical trial 2023-508640-21-00: Treatment of patellofemoral osteoarthritis with nasal chondrocyte-based engineered cartilage implantation in a randomized, controlled, multi-center phase II clinical trial
Protocol code: PFOA II
Sponsor: Universitaetsspital Basel (Hospital/Clinic/Other health care facility). Phase: Therapeutic exploratory (Phase II). Countries: Germany (authorised, recruitment pending), Croatia (ongoing, recruiting).
Therapeutic area(s): Diseases [C] - Musculoskeletal Diseases [C05]
Gender: Female, Male. Age: 18-64 years. Enrolment: 30.
Start date (EU): 2025-09-22. Decision date: 2024-09-27. Results received: No. Last updated: 2026-01-30.
Decision dates by country: DE: 2024-09-27, HR: 2025-03-10

Condition(s): Patellofemoral osteoarthritis
Product: N-TEC

Primary endpoint: Comparison of mean change in KOOS Pain from baseline to 24 months between groups (N-TEC – PRP > 15)
Endpoint(s): Mean KOOS Pain at 6 and 12 months, Mean KOOS subscales (Symptoms, Activity of daily living (ADL), Sports & Recreation (Sports), Quality of Life (QOL)) at 6, 12 and 24 months, Kujala Anterior Knee Pain Scale at 6, 12 and 24 months, WOMAC Score at 6, 12 and 24 months, EQ-5D-5L at 6, 12 and 24 months, VAS at 6, 12 and 24 months, Number of treatment failures and subjects non-responding (improvement in KOOS Pain < 13 on a scale of 0-100) at 24 months, Global Rating Of Change (GROC) likert scale at 6, 12 and 24 months, MARS at 6, 12 and 24 months, MRI Osteoarthritis Knee Score (MOAKS) for radiological evaluation of osteoarthritis at 6, 12 and 24 months, MRI of Cartilage Repair Tissue (MOCART) for radiological evaluation of repair tissue at 6, 12 and 24 months, Osteoarthritis grade according to Iwano and Kellgren/Lawrence classification at 6, 12 and 24 months, Number of SARs and SUSARs to assess safety

Source: https://euclinicaltrials.eu/ctis-public/view/2023-508640-21-00